EU clinical trial 2023-503459-91-00: A Phase 1b/2a Three-Part Open-Label Multicenter Study to Evaluate the Safety and Efficacy of LY2880070 as Monotherapy and in Combination with Gemcitabine in Patients with Advanced or Metastatic Cancer with a Focus on Ovarian Cancer
Protocol code: ESPS-001(m)
Sponsor: Esperas Pharma Inc. (Pharmaceutical company). Phase: Therapeutic exploratory (Phase II). Countries: Poland (ended), Croatia (ended).
Therapeutic area(s): Diseases [C] - Neoplasms [C04]
Gender: Female. Age: 18-64 years, 65+ years. Enrolment: 12.
Status: Ended. Start date (EU): 2023-11-21. End date (EU): 2025-04-07. End date: 2025-04-14. Decision date: 2023-08-28. Results received: Yes. Last updated: 2025-03-17.
Decision dates by country: PL: 2023-08-28, HR: 2023-08-28

Condition(s): Advanced or Metastatic Cancer
Product: Gemcitabine Kabi 38 mg/ml koncentrát pro infuzní roztok, GEMSOL, 40 MG/ML, KONCENTRAT DO SPORZĄDZANIA ROZTWORU DO INFUZJI

Primary endpoint: Safety (treatment emergent adverse events, serious adverse events, and clinical abnormalities per Common Terminology Criteria for Adverse Event)
Endpoint(s): overall response rate, disease control rate

Source: https://euclinicaltrials.eu/ctis-public/view/2023-503459-91-00